EU clinical trial 2025-521970-33-00: An Open-label Long-term Follow-up Study to Evaluate the Effects of Sotatercept When Added to Background Pulmonary Arterial Hypertension (PAH) Therapy for the Treatment of PAH (MK-7962-038)
Protocol code: MK-7962-038
Sponsor: Merck Sharp & Dohme LLC (Pharmaceutical company). Phase: Therapeutic confirmatory (Phase III). Countries: Czechia (ongoing, recruitment ended), Germany (ongoing, recruiting), Sweden (ongoing, recruitment ended), Greece (ongoing, recruitment ended), Croatia (ongoing, recruitment ended), Belgium (ongoing, recruitment ended), Poland (ongoing, recruitment ended), Spain (ongoing, recruitment ended), Portugal (ongoing, recruitment ended), Italy (ongoing, recruitment ended), Denmark (ongoing, recruitment ended), France (ongoing, recruiting), Netherlands (ongoing, recruitment ended).
Therapeutic area(s): Diseases [C] - Cardiovascular Diseases [C14]
Gender: Female, Male. Age: 18-64 years, 65+ years. Enrolment: 389.
Start date (EU): 2025-12-19. Decision date: 2025-12-01. Results received: No. Last updated: 2026-05-06.
Decision dates by country: HR: 2025-12-08, CZ: 2025-12-02, ES: 2025-12-09, SE: 2025-12-02, DK: 2026-02-25, FR: 2025-12-02, BE: 2025-12-05, DE: 2025-12-04, GR: 2025-12-02, IT: 2025-12-05, PL: 2025-12-08, PT: 2025-12-05, NL: 2025-12-04

Condition(s): Pulmonary Arterial Hypertension (PAH)
Product: SOTATERCEPT, SOTATERCEPT, sotatercept, sotatercept

Primary endpoint: Number of Participants Who Experience an Adverse Event (AE), Number of Participants Who Discontinue Study Treatment Due to an AE, Number of Participants With Detectable Anti-drug Antibodies (ADAs), Hematology Parameters: Concentration of Red Blood Cell Count, White Blood Cell Count, Platelet Count, Hemoglobin, and Hematocrit, Chemistry Parameters: Concentration of Blood Urea,Creatinine,Total & Direct Bilirubin,Aspartate Aminotransferase,Alanine Transaminase,Alkaline Phosphatase,Sodium,Potassium,Chloride,Calcium,Phosphorous,Glucose,Magnesium,Carbon Dioxide, & Albumin, Change From Baseline in Body Weight, Change From Baseline in Blood Pressure, Change From Baseline in Electrocardiogram (ECG)
Endpoint(s): Change From Baseline in 6-Minute Walk Distance (6MWD), Change From Baseline in N-Terminal Pro-Hormone B-type Natriuretic Peptide (NT-proBNP) Levels, Change From Baseline in the Percentage of Participants Who Improve or Show Maintenance in Modified New York Heart Association/World Health Organization Classification of Functional Status (WHO FC), Change From Baseline in Pulmonary Vascular Resistance (PVR), Change From Baseline in Percentage of Participants Who Maintain or Achieve a Low-Risk Score Using the Simplified French Risk Score Calculator

Source: https://euclinicaltrials.eu/ctis-public/view/2025-521970-33-00